EU clinical trial 2024-515979-35-00: A Phase 3, Multicenter, Randomized, Placebo-Controlled, Double-Blind Study to Assess the Efficacy and Safety of IMVT-1402 in Patients With Mild to Severe Generalized Myasthenia Gravis
Protocol code: IMVT-1402-3101
Sponsor: Immunovant Sciences GmbH (Pharmaceutical company). Phase: Therapeutic confirmatory (Phase III). Countries: Czechia (ongoing, recruiting), Greece (ongoing, recruiting), Spain (ongoing, recruiting), Italy (ongoing, recruiting), Denmark (ongoing, recruiting), Germany (ongoing, recruiting), Romania (ongoing, recruiting), Poland (ongoing, recruiting), Hungary (ongoing, recruiting).
Therapeutic area(s): Diseases [C] - Nervous System Diseases [C10]
Gender: Female, Male. Age: 18-64 years, 65+ years. Enrolment: 158.
Status: Ongoing, recruiting. Start date (EU): 2025-11-13. Decision date: 2025-10-20. Results received: No. Last updated: 2026-07-07.
Decision dates by country: DK: 2025-10-20, ES: 2025-10-23, IT: 2025-10-21, CZ: 2025-10-20, RO: 2025-10-27, HU: 2025-10-27, GR: 2025-10-20, DE: 2025-10-27, PL: 2026-02-24

Condition(s): Generalized Myasthenia Gravis
Product: IMVT-1402, Placebo is identical to IMP but with no active substance

Primary endpoint: Change from baseline in MG-ADL Score for Antibody-positive Participants
Endpoint(s): Change from baseline in Quantitative Myasthenia Gravis (QMG) Score for Antibody-positive Participants, Percentage of Antibody-positive Participants Achieving MG-ADL Score of 0 or 1, Percentage of Antibody-Positive Participants with ≥50% Improvement in MG-ADL Score

Source: https://euclinicaltrials.eu/ctis-public/view/2024-515979-35-00